EU clinical trial 2023-507677-18-00: A Phase 1/2 Clinical Trial to Evaluate the Safety, Tolerability, Pharmacokinetics, and Efficacy of TERN-701 in Participants with Chronic Myeloid Leukemia
Protocol code: TERN701-1012
Sponsor: Terns Inc. (Pharmaceutical company). Phase: Phase I and Phase II (Integrated)- Other. Countries: Germany (ongoing, recruiting), France (ongoing, recruiting), Spain (ongoing, recruiting), Italy (ongoing, recruiting).
Therapeutic area(s): Diseases [C] - Neoplasms [C04]
Gender: Female, Male. Age: 18-64 years. Enrolment: 103.
Status: Ongoing, recruiting. Start date (EU): 2024-05-17. Decision date: 2024-04-22. Results received: No. Last updated: 2026-06-01.
Decision dates by country: ES: 2024-04-22, IT: 2024-04-24, FR: 2024-04-29, DE: 2024-04-24

Condition(s): Chronic Myeloid Leukemia

Source: https://euclinicaltrials.eu/ctis-public/view/2023-507677-18-00